EU clinical trial 2023-504351-26-01: Randomized trial comparing efficacy and safety of initial triple therapy including parenteral treprostinil to initial double oral therapy in PAH group I patients – TripleTRE
Protocol code: TREV1-10P.401
Sponsor: Aop Orphan Pharmaceuticals GmbH (Pharmaceutical company). Phase: Phase III and phase IV (Integrated). Countries: Italy (ongoing, recruiting), Germany (ongoing, recruiting), France (ongoing, recruiting), Austria (ongoing, recruiting), Czechia (ongoing, recruiting), Hungary (ongoing, recruiting), Portugal (ongoing, recruiting), Romania (ongoing, recruiting), Spain (ongoing, recruiting), Poland (ongoing, recruiting), Slovakia (authorised, recruitment pending), Netherlands (authorised, recruitment pending).
Therapeutic area(s): Diseases [C] - Cardiovascular Diseases [C14]
Gender: Female, Male. Age: 18-64 years, 65+ years. Enrolment: 150.
Start date (EU): 2023-12-06. Decision date: 2023-09-28. Results received: No. Last updated: 2026-06-30.
Decision dates by country: AT: 2023-10-02, IT: 2023-09-29, PL: 2024-06-24, DE: 2023-09-28, NL: 2026-05-11, RO: 2024-03-04, SK: 2025-12-15, FR: 2023-09-29, CZ: 2024-02-29, PT: 2024-05-02, HU: 2024-02-28, ES: 2024-03-01

Condition(s): Pulmonary arterial hypertension (group I)
Product: Trisuva 2,5 mg/ml Infusionslösung, TREPOSUVI 5 mg/ml, solution pour perfusion, Tresuvi 2,5 mg/ml soluzione per infusione, TREPOSUVI 10 mg/ml, solution pour perfusion, Trisuva 10 mg/ml Infusionslösung, Tresuvi 1 mg/ml soluzione per infusione, Tresuvi 5 mg/ml Infusionslösung, Tresuvi 1 mg/ml Infusionslösung, Tresuvi 10 mg/ml soluzione per infusione, TREPOSUVI 2,5 mg/ml, solution pour perfusion, Trisuva 1 mg/ml Infusionslösung, Tresuvi 10 mg/ml Infusionslösung, Trisuva 5 mg/ml Infusionslösung, Tresuvi 2,5 mg/ml Infusionslösung, TREPOSUVI 1 mg/ml, solution pour perfusion, Tresuvi 5 mg/ml soluzione per infusione

Primary endpoint: (Non)Response to the assigned treatm.: 1.Therapy-responder: achievem. of low-risk status betw. wk 24 and wk 48 2.Therapy-non-responder: a) PH related deterioration to high-risk status, lung transplantation or death betw. wk 12 and wk 48 or b) additional medication or change of initial PH specific medication due to unsatisfactory efficacy betw. wk 12 and wk 48 or c)low risk status not achieved up to wk 48. Risk status assessed with the simpl. four-strata risk-assessm. tool as per PH guidelines
Endpoint(s): Change in haemodynamic parameters by means of right heart catheterization (RHC) between baseline and week 24: a. Pulmonary Vascular Resistance (PVR) b. Mean pulmonary arterial pressure (mPAP) c. Mean right atrial pressure (mRAP) d. Cardiac index (CI) e. Cardiac output (CO) f. Stroke volume index (SVI), Change in right heart structure and function assessed by echocardiography between baseline and week 24: a. RV-PA coupling estimated by the ratio of tricuspid annular plane systolic excursion by pulmonary artery systolic pressure (TAPSE/sPAP) b. RV end-diastolic area (RVEDA) c. RV end-systolic area (RVESA) d. RV fractional area change (RVFAC) e. Right atrium (RA) area f. Pericardial effusion, Time to achievement of low-risk status assessed by the simplified four-strata risk-assessment tool, Rate of change of risk status by means of the simplified four-strata risk-assessment tool, Change in the number of low-risk criteria based on the French PH Network Registry (FPHR) risk assessment tool between baseline and week 24, Change in REVEAL 2.0 risk score between baseline and week 24, Rate of change in WHO FC, Rate of change in 6MWD, Rate of change in NT-proBNP/BNP levels, Change in quality of life by questionnaires emPHasis-10 and EQ-5D-5L, Total number of clinical worsening where clinical worsening is defined as: a) PAH related death (including all deaths where PAH cannot be excluded as cause) or lung transplantation due to PAH b) PH-related hospitalization c) Post baseline (screening visit) decrease in 6MWD by 15% d) Post baseline (screening visit) worsening of WHO FC, Overall and transplant free survival, Adverse events (AE), Adverse reactions (ADR), Serious Adverse events (SAE), Serious Adverse Drug Reactions (SADR), Suspected unexpected serious adverse reactions (SUSAR)

Source: https://euclinicaltrials.eu/ctis-public/view/2023-504351-26-01